EU clinical trial 2024-518962-29-00: Riluzole (Glentek) in patients with SpinoCerebellar Ataxia type 7: a randomized, doubleblind, placebo-controlled pilot trial with a lead in phase
Protocol code: AIFA-2016-02365063
Sponsor: Universita Degli Studi Di Roma La Sapienza (Educational Institution). Phase: Therapeutic exploratory (Phase II). Countries: Italy (ongoing, recruiting).
Therapeutic area(s): Diseases [C] - Nervous System Diseases [C10]
Gender: Female, Male. Age: 0-17 years, 18-64 years, 65+ years. Enrolment: 24.
Status: Ongoing, recruiting. Start date (EU): 2021-12-07. Decision date: 2024-11-27. Results received: No. Last updated: 2025-10-27.

Condition(s): Spinocerebellar ataxia type 7 (SCA7)
Product: Glentek 50 mg filmtabletten, Placebo Riluzole is a hard gelatin capsule filled with the inert excipient microcrystalline cellulose (Avicel® PH200).

Primary endpoint: The primary endpoints will be the proportion of patients with stable SARA score and visual acuity expressed as log MAR units at 18 months, in comparison with the same parameters as mean of t0-t3-t6 evaluations .
Endpoint(s): The secondary endpoint will be quantitative ophthalmologic assessments (via a Farnsworth D15 Arrangement Test, Visual evoked, Electroretinography, Optical Coherence tomography, Computerized visual field examination) and SARA score as continuous values at 18 months, in comparison with the same parameters calculated for each patient as mean of t0-t3-t6 evaluations, The safety profile will be assessed through the recording, reporting and analyzing of baseline medical conditions, adverse events, physical examination findings including laboratory tests.

Source: https://euclinicaltrials.eu/ctis-public/view/2024-518962-29-00